EU clinical trial 2025-522512-16-00: Phase 1 trial of valemetostat and darolutamide in mCRPC
Protocol code: DS3201-343
Sponsor: Daiichi Sankyo Inc. (Pharmaceutical company). Phase: Human Pharmacology (Phase I)- Other. Countries: Ireland (ongoing, recruiting), Spain (ongoing, recruiting), France (ongoing, recruiting).
Therapeutic area(s): Diseases [C] - Neoplasms [C04]
Gender: Male. Age: 18-64 years, 65+ years. Enrolment: 13.
Status: Ongoing, recruiting. Start date (EU): 2026-04-23. Decision date: 2026-03-18. Results received: No. Last updated: 2026-05-04.
Decision dates by country: IE: 2026-03-20, ES: 2026-03-19, FR: 2026-05-04

Condition(s): Metastatic Castration Resistant Prostate Cancer (mCRPC)

Source: https://euclinicaltrials.eu/ctis-public/view/2025-522512-16-00